EU clinical trial 2024-517414-15-00: TRAK-ER_A randomised trial of early detection of molecular relapse with circulating tumour DNA tracking and treatment with palbociclib plus fulvestrant versus standard endocrine therapy in patients with ER positive HER2 negative breast cancer
Protocol code: CCR5316
Sponsor: The Royal Marsden NHS Foundation Trust (Hospital/Clinic/Other health care facility). Phase: Therapeutic exploratory (Phase II). Countries: France (ongoing, recruiting).
Therapeutic area(s): Diseases [C] - Neoplasms [C04]
Gender: Female, Male. Age: 18-64 years, 65+ years. Enrolment: 550.
Status: Ongoing, recruiting. Start date (EU): 2023-01-25. Decision date: 2024-10-08. Results received: No. Last updated: 2024-10-08.

Condition(s): ER positive HER2 negative breast cancer
Product: FULVESTRANT, ANASTROZOLE, PALBOCICLIB, TAMOXIFEN, LETROZOLE, EXEMESTANE

Primary endpoint: Surveillance Phase: • ctDNA detection – Total ctDNA detection and breakdown by incidence at first ctDNA test verses incidence at subsequent ctDNA tests, Treatment Phase: • Relapse free survival – Time from randomization to invasive local/regional recurrence (including ipsilateral invasive breast recurrence) or distant recurrence or death from any cause. Patients with second primary invasive cancers (breast or non-breast) would be censored at time of detection.
Endpoint(s): • Relapse free interval – Time from randomisation to invasive local/regional recurrence (including ipsilateral invasive breast recurrence) or distant invasive recurrence. All deaths and second primary invasive cancers (breast or non-breast) would be censored at time of detection., • Invasive disease free survival – Time from randomisation to invasive local/regional recurrence (including ipsilateral invasive breast recurrence), new breast cancer (ipsilateral or contralateral) or distant recurrence or death from any cause. Patients with non-invasive recurrences or second primary invasive cancers (non-breast) would be censored at time of detection., • Distant recurrence free survival - Time from randomization to distant invasive breast cancer recurrence or death from any cause. Patients with new contralateral invasive breast cancers or second primary invasive non-breast cancers would be censored at time of detection., • Overall survival – Time from randomisation to death from any cause., • ctDNA clearance – Absence of detectable ctDNA and disease recurrence at 24 weeks. Additional timepoints will be assessed in exploratory analysis (e.g. 52 weeks)., • Safety and tolerability – Assessed by Adverse Events (AEs) as per CTCAE v5 and quality of life as measured with EQ-5D-5L and EORTC C30 and BR23 questionnaires, • Overt advanced disease (metastatic disease or incurable locally advanced disease) at time of ctDNA detection at the time of first ctDNA detection, and subsequent ctDNA tests., • Isolated local recurrence (recurrence in ipslilateral breast or ipsilateral regional lymph nodes treatable with potentially curative intent) at the time at time of ctDNA detection at the time of first ctDNA detection, and subsequent ctDNA tests., • Proportion of recurrences detected by ctDNA – the proportion of recurrences that have ctDNA detected prior to recurrence compared to the total number of recurrences during the period of ctDNA surveillance., • Level of ctDNA detection – the allele fraction of ctDNA at the time of first ctDNA detection., • Lead time to recurrence on standard of care – the time from the date of ctDNA detection to invasive local/regional recurrence (including ipsilateral invasive breast recurrence) in the standard of care endocrine therapy group. All deaths and second primary invasive cancers (breast or non-breast) would be censored.

Source: https://euclinicaltrials.eu/ctis-public/view/2024-517414-15-00